EU clinical trial 2024-519511-33-00: A Phase IIa Trial Evaluating the Efficacy of anti-CD19 Chimeric Antigen Receptor Engineered T-Cells in Patients With Systemic Sclerosis (SSc) Resistant to Immunosuppressive Drugs. SCLEROCAR
Sponsor: Centre Hospitalier Universitaire De Montpellier (Hospital/Clinic/Other health care facility). Phase: Therapeutic exploratory (Phase II). Countries: France (ongoing, recruiting).
Therapeutic area(s): Diseases [C] - Immune System Diseases [C20]; Diseases [C] - Skin and Connective Tissue Diseases [C17]
Gender: Female, Male. Age: 18-64 years. Enrolment: 6.
Status: Ongoing, recruiting. Start date (EU): 2026-06-11. Decision date: 2025-11-07. Results received: No. Last updated: 2026-06-02.

Condition(s): Patients will be included with a stable but active disease (as defined Diagnosis of systemic sclerosis according to ACR/EULAR classification by EUSTAR ≥2.5) or to patients with a worsening disease despite low dose steroids and at least 2 immunosuppressive treatment including DMARDs (methotrexate, azathioprine, mycophenolate mofetil) and/or a biological DMARD (rituximab or tocilizumab) for at least 6 months.
Product: MB-CART19.1

Primary endpoint: Improvement of disease activity assessed from baseline to month 6 after CAR T ANTI-CD19 cell administration through change of at least 5 points in the modified Rodnan Skin Score (mRSS).
Endpoint(s): Change in the EUSTAR activity index (EUSTAR AI), Change in mRSS, Change in the lung capacity FVC (forced vital capacity) and DLCO, Extension of fibrosis through pulmonary TDM, Change in cardiac ejection fraction and global longitudinal strain, Change in scleroderma-adapted Health Assessment Questionnaire (SHAQ) score., Change in Health Assessment Questionnaire Disability Index HAQ-DI score, Incidence rate of adverse events, Incidence rate of AE of special interest (AESI), Pharmacokinetic parameters linked to CART quantification (Tmax, Cmax, AUC), as well as the subpopulations of B and T immune cells,

Source: https://euclinicaltrials.eu/ctis-public/view/2024-519511-33-00